EU clinical trial 2025-521833-97-00: A Phase IV, non-randomized, open-label multinational trial to assess the mechanism of action for Lebrikizumab in moderate-to-severe atopic dermatitis
Sponsor: University Of Michigan (Educational Institution). Phase: Therapeutic use (Phase IV). Countries: Germany (authorised, recruitment pending).
Therapeutic area(s): Diseases [C] - Immune System Diseases [C20]; Diseases [C] - Skin and Connective Tissue Diseases [C17]; Diseases [C] - Congenital, Hereditary, and Neonatal Diseases and Abnormalities [C16]
Gender: Female, Male. Age: 18-64 years, 65+ years. Enrolment: 12.
Status: Authorised, recruitment pending. Decision date: 2025-08-04. Results received: No. Last updated: 2026-04-24.

Condition(s): Moderate-to-severe atopic dermatitis
Product: Ebglyss 250 mg solution for injection in pre-filled syringe

Primary endpoint: Degree of normalization of transcriptomic and epigenetic profile in skin biopsies from baseline over time, measuring molecular changes after treatment with lebrikizumab
Endpoint(s): 1. Molecular (transcriptomic/epigenetic) response to lebrikizumab among patients with atopic dermatitis at baseline to weeks 2, 24, 36, and 60., 2. Molecular (transcriptomic/epigenetic) change to lebrikizumab among patients with atopic dermatitis at baseline to weeks 2, 24, 36, and 60., 3. Molecular (transcriptomic/epigenetic) response after lebrikizumab discontinuation among patients with atopic dermatitis from week 36 to week 60 in the withdrawal arm and active treatment arm., 4. Molecular (transcriptomic/epigenetic) changes after lebrikizumab discontinuation among patients with atopic dermatitis from week 36 to week 60 in the withdrawal arm and active treatment arm., 5. Improvement in skin barrier function as assessed by serial TEWL measurements in lesional skin from baseline to week 60 in all subjects., 6. Correlation between clinical response (EASI/IGA and Pruitis NRS) with molecular (transcriptomic/epigenetic) at weeks 2, 24, 36, and 60.

Source: https://euclinicaltrials.eu/ctis-public/view/2025-521833-97-00